EU clinical trial 2025-522916-17-00: Phase 1, Open-Label, single arm (Non-comparator) Study to Evaluate the Pharmacokinetics and Safety of a Single Dose of Oral Gepotidacin in Addition to Antibacterial Standard of Care in Pediatric Participants from 2 to less than 12 years of age with a Suspected or Confirmed Bacterial Infection or Receiving Prophylaxis with Antibiotics
Protocol code: 222778
Sponsor: Glaxosmithkline Research & Development Limited (Pharmaceutical company). Phase: Human Pharmacology (Phase I)- Other. Countries: Spain (authorised, recruitment pending), Poland (authorised, recruitment pending).
Therapeutic area(s): Diseases [C] - Bacterial Infections and Mycoses [C01]
Gender: Female, Male. Age: 0-17 years. Enrolment: 5.
Status: Authorised, recruitment pending. Decision date: 2026-04-09. Results received: No. Last updated: 2026-04-09.
Decision dates by country: PL: 2026-04-09, ES: 2026-04-09

Condition(s): Urinary Tract Infections

Primary endpoint: •AUC from time zero to the time of the last quantifiable concentration (AUC[0-t]) of gepotidacin., •Area under the concentration-time curve from time zero extrapolated to infinite time (AUC[0-inf]) of gepotidacin., •Maximum observed plasma concentration (Cmax) of gepotidacin., •Apparent oral clearance (CL/F) of gepotidacin., •Apparent volume of distribution (Vz/F) of gepotidacin., •Terminal phase half-life (t1/2) of gepotidacin.
Endpoint(s): •Number of participants with Adverse events (AEs), Adverse Events of Special Interest (AESI) and Serious Adverse Events (SAEs);, •Change from baseline in vital signs: Temperature;, •Change from baseline in vital signs: Blood Pressure;, •Change from baseline in vital signs: Pulse Rate;, •Change from baseline in Electrocardiogram (ECG).

Source: https://euclinicaltrials.eu/ctis-public/view/2025-522916-17-00